EU clinical trial 2024-514225-30-00: Phase 1, first-in-human trial to evaluate the safety, tolerability, and pharmacokinetics of ascending single oral doses of octreotide/ LipOra peptide in healthy volunteers
Protocol code: K817, LipOra trial
Sponsor: Universitaetsklinikum Heidelberg AöR (Hospital/Clinic/Other health care facility). Phase: Human Pharmacology (Phase I)- First administration to humans. Countries: Germany (ended).
Therapeutic area(s): Diseases [C] - Hormonal diseases [C19]
Gender: Female, Male. Age: 18-64 years. Enrolment: 45.
Status: Ended. Start date (EU): 2023-07-11. End date (EU): 2025-04-01. Decision date: 2024-08-23. Results received: No. Last updated: 2025-02-12.

Condition(s): Acromegalia

Source: https://euclinicaltrials.eu/ctis-public/view/2024-514225-30-00